EU clinical trial 2023-507692-21-00: Phase Ib Open Label Basket Trial of RAY121 to Inhibit Classical Complement Pathway in Immunological Diseases (RAINBOW Trial)
Protocol code: RAY902CT
Sponsor: Chugai Pharmaceutical Co. Ltd. (Pharmaceutical company). Phase: Human Pharmacology (Phase I)- Other. Countries: Spain (ongoing, recruiting), Poland (ongoing, recruiting), Hungary (ongoing, recruiting), Bulgaria (ongoing, recruiting), Italy (ongoing, recruiting), Netherlands (ongoing, recruiting), Romania (ongoing, recruiting), France (ongoing, recruiting), Germany (ongoing, recruiting), Austria (ended), Croatia (ongoing, recruiting), Czechia (ended), Portugal (authorised, recruiting), Norway (ongoing, recruiting).
Therapeutic area(s): Diseases [C] - Immune System Diseases [C20]
Gender: Female, Male. Age: 18-64 years, 65+ years. Enrolment: 87.
Start date (EU): 2024-08-22. Decision date: 2024-07-09. Results received: No. Last updated: 2026-06-19.
Decision dates by country: HU: 2024-07-12, FR: 2024-07-12, DE: 2024-08-23, PT: 2024-11-12, BG: 2024-07-15, NL: 2024-07-09, RO: 2024-07-15, CZ: 2024-11-21, HR: 2024-11-25, AT: 2024-07-15, NO: 2024-10-30, PL: 2024-07-15, IT: 2024-07-09, ES: 2024-07-11

Condition(s): Antiphospholipid syndrome, Bullous pemphigoid, Behçet’s Syndrome, Immune-mediated necrotizing myopathy, Dermatomyositis, Immune Thrombocytopenia

Source: https://euclinicaltrials.eu/ctis-public/view/2023-507692-21-00